EU clinical trial 2023-510172-31-00: A Phase III, 52-week, Multinational, Multicenter, Randomized, Double-blind, 2-arm Parallel Group Study Comparing Efficacy, Safety and Tolerability of the Fixed Dose Triple Combination of Beclomethasone Dipropionate Plus Formoterol Fumarate Plus Glycopyrronium Bromide (CHF 5993) With the Fixed Dose Dual Combination of Beclomethasone Dipropionate Plus Formoterol Fumarate (CHF 1535), Both Administered Via pMDI in Subjects With Chronic Obstructive Pulmonary Disease (COPD)
Protocol code: CLI-05993AA3-06
Sponsor: Chiesi Farmaceutici S.p.A. (Pharmaceutical company). Phase: Therapeutic confirmatory (Phase III). Countries: Hungary (ended), Poland (ended), Czechia (ended), Bulgaria (ended), Romania (ended).
Therapeutic area(s): Diseases [C] - Respiratory Tract Diseases [C08]
Gender: Female, Male. Age: 18-64 years, 65+ years. Enrolment: 1149.
Status: Ended. Start date (EU): 2022-04-22. End date (EU): 2025-12-29. End date: 2026-01-13. Decision date: 2024-06-06. Results received: No. Last updated: 2026-01-13.
Decision dates by country: PL: 2024-06-17, CZ: 2024-06-10, RO: 2024-09-16, BG: 2024-09-12, HU: 2024-06-06

Condition(s): Chronic obstructive pulmonary disease (COPD)
Product: training kit, CHF1535 pMDI 100/6, CHF5993 pMDI-US

Primary endpoint: Change from baseline in pre-dose morning FEV1 at week 28 (V7)
Endpoint(s): Change from baseline in 2-hour post-dose morning FEV1 at week 28 (V7), Rate of moderate and severe COPD exacerbations over 52 weeks of treatment, SGRQ response (Decrease from baseline in total score ≥4) at Week 28, Incidence of treatment-emergent adverse events (TEAEs), adverse drug reactions (ADRs), serious ADRs, serious AEs (SAEs), severe AEs, TEAEs leading to discontinuation from study drug, and TEAEs leading to death, Incidence of treatment-emergent pneumonia, Incidence of treatment-emergent major adverse cardiovascular events (MACE).

Source: https://euclinicaltrials.eu/ctis-public/view/2023-510172-31-00